EU clinical trial 2024-516574-30-00: Phase I trial of the new drug PhOx430 (inhibitor of the enzyme glucosaminyltransferase V) in patients with advanced solid tumors; first test of a drug of this class in human beings.
Protocol code: PHOX-CLI-001
Sponsor: Phost'In Therapeutics (Pharmaceutical company). Phase: Human Pharmacology (Phase I)- First administration to humans. Countries: Italy (ongoing, recruitment ended), France (ongoing, recruitment ended).
Therapeutic area(s): Diseases [C] - Neoplasms [C04]
Gender: Female, Male. Age: 18-64 years, 65+ years. Enrolment: 149.
Status: Ongoing, recruitment ended. Start date (EU): 2024-10-15. Decision date: 2024-10-15. Results received: No. Last updated: 2025-05-20.
Decision dates by country: FR: 2024-10-17, IT: 2024-10-15

Condition(s): Adult patients with advanced or metastatic solid malignancies with radiologically documented progression on a previous line of treatment and for which effective treatment options do not exist.

Source: https://euclinicaltrials.eu/ctis-public/view/2024-516574-30-00